EU clinical trial 2023-507431-37-00: An Open-Label, Rater-Blind, Randomized, Multi-Center, Parallel-Arm, Active-Comparator Study to Assess the Efficacy and Tolerability of Ofatumumab 20mg SC monthly vs. First Line DMT - physician’s choice in the treatment of newly diagnosed RMS (STHENOS)
Protocol code: COMB157G3301
Sponsor: Novartis Pharma AG (Pharmaceutical company). Phase: Therapeutic confirmatory (Phase III). Countries: France (ended), Germany (ended), Italy (ended), Spain (ended).
Therapeutic area(s): Diseases [C] - Nervous System Diseases [C10]
Gender: Female, Male. Age: 18-64 years. Enrolment: 186.
Status: Ended. Start date (EU): 2021-07-23. End date (EU): 2025-11-04. End date: 2025-11-05. Decision date: 2024-06-27. Results received: No. Last updated: 2025-06-02.
Decision dates by country: IT: 2024-07-01, FR: 2024-07-11, ES: 2024-06-27, DE: 2024-06-27

Condition(s): relapsing multiple sclerosis (RMS)
Product: TERIFLUNOMIDE, INTERFERON BETA-1A, DIROXIMEL FUMARATE, INTERFERON BETA-1A, INTERFERON BETA-1A, GLATIRAMER ACETATE, Betaferon 250 microgram/ml, powder and solvent for solution for injection, OFATUMUMAB, GLATIRAMER ACETATE, DIMETHYL FUMARATE, PEGINTERFERON BETA-1A, DIMETHYL FUMARATE

Primary endpoint: NEDA-3 status (yes or no) NEDA-3 is defined as: 1. Absence of confirmed clinical relapse 2. Absence of new MRI activity (Gd+ T1 lesion or new/enlarged T2 lesion) with MRI re-baselined at Month 3 3. Absence of 3-month confirmed disability worsening
Endpoint(s): Number of relapses up to Month 15/ EOS, Annual Relapse Rate (ARR), Mean time to first relapse, Proportion of relapse-free patients at Month 3, 9 and 15, Proportion of relapse-free patients with MRI activity-free (no new Gd+ T1 lesion or new/enlarged T2 lesion) at Month 3, 9 and 15, Time to 3-month Confirmed Disability Worsening (3mCDW), Time to 6-month Confirmed Disability Worsening (6mCDW), Change in expanded disability status scale (EDSS) from Baseline to end of study, Proportion of disability progression free patient at EOS, Number of Gadolinium enhancing (Gd+) T1 lesions of brain, Volume of Gd+ T1 lesions of brain, Number of new/enlarging T2 lesions of brain, Volume of new/enlarging T2 lesions of brain, Proportion of SAEs, and SAEs with hospitalizations between ofatumumab 20 mg s.c. and first line self-administered DMTs, Proportion of patients with adverse events, including injection related reactions, Proportion of patients who withdrew due to abnormal lab values, Proportion of treatment discontinuation or interruptions for safety/ tolerability reason, Compliance to treatment using patient diary

Source: https://euclinicaltrials.eu/ctis-public/view/2023-507431-37-00